EU clinical trial 2022-502092-33-00: ETOP 23-22 RAISE: A single-arm phase II study of the addition of niraparib to anti-PD-L1 antibody maintenance in patients with SLFN11-positive, extensive-disease small cell lung cancer.
Protocol code: ETOP 23-22 RAISE
Sponsor: ETOP IBCSG Partners Foundation (Laboratory/Research/Testing facility). Phase: Therapeutic exploratory (Phase II). Countries: Spain (ongoing, recruiting), France (ongoing, recruiting), Italy (ongoing, recruiting), Romania (ended), Germany (ongoing, recruiting).
Therapeutic area(s): Diseases [C] - Neoplasms [C04]; Diseases [C] - Respiratory Tract Diseases [C08]
Gender: Female, Male. Age: 18-64 years, 65+ years. Enrolment: 35.
Start date (EU): 2024-05-31. Decision date: 2024-02-19. Results received: No. Last updated: 2026-03-09.
Decision dates by country: RO: 2024-02-20, DE: 2025-09-29, FR: 2024-05-28, IT: 2024-02-19, ES: 2024-02-15

Condition(s): Extensive-disease small cell lung cancer and high SLFN11-expression
Product: IMFINZI 50 mg/mL concentrate for solution for infusion., Tecentriq 1 200 mg concentrate for solution for infusion, IMFINZI 50 mg/mL concentrate for solution for infusion., Tecentriq 840 mg concentrate for solution for infusion

Primary endpoint: Progression-free survival (PFS) rate at 3 months by investigator assessment (according to RECIST v1.1)
Endpoint(s): • Progression-free survival (PFS) • Overall survival (OS) • Disease control rate (DCR) by investigator assessment (according to RECIST v1.1) • Adverse events according to CTCAE v5.0

Source: https://euclinicaltrials.eu/ctis-public/view/2022-502092-33-00